EU clinical trial 2023-504846-73-01: A multicenter randomized double-blinded controlled phase 2 study evaluating the efficacy of valganciclovir as add-on therapy in glioblastoma patients
Protocol code: Protocol number 8
Sponsor: Karolinska Institutet (Educational Institution). Phase: Therapeutic exploratory (Phase II). Countries: Sweden (authorised, recruitment pending), Norway (authorised, recruitment pending).
Therapeutic area(s): Analytical, Diagnostic and Therapeutic Techniques and Equipment [E] - Therapeutics [E02]; Diseases [C] - Neoplasms [C04]; Diseases [C] - Virus Diseases [C02]
Gender: Female, Male. Age: 18-64 years, 65+ years. Enrolment: 220.
Status: Authorised, recruitment pending. Decision date: 2024-10-29. Results received: No. Last updated: 2024-10-29.
Decision dates by country: SE: 2024-10-29, NO: 2024-10-29

Condition(s): Glioblstoma WHO grade IV
Product: Placebo tablets are produced with the same appearance as the Valganciclovir tablets, with the same content except for the active compound., VALGANCICLOVIR

Primary endpoint: Compare median overall survival (OS) time in patients with newly-diagnosed glioblastoma and less than 1 cm3 remaining contrast enhancing tumor postoperatively treated with and without valganciclovir as add-on to standard therapy. The primary endpoint is median OS at End of Study (EoS) when the last patient has reached 30 months. OS time is measured from time of resection until death for any reason.
Endpoint(s): Compare different survival and toxicity parameters in patients with newly-diagnosed glioblastoma treated with and without valganciclovir as add-on to standard therapy.

Source: https://euclinicaltrials.eu/ctis-public/view/2023-504846-73-01